EU clinical trial 2024-520132-15-00: The effect of music on perioperative anxiety and pain of patients undergoing retrobulbar anaesthesia
Sponsor: Medical University Of Graz (Educational Institution). Phase: Phase III and phase IV (Integrated). Countries: Austria (ongoing, recruiting).
Therapeutic area(s): Analytical, Diagnostic and Therapeutic Techniques and Equipment [E] - Anesthesia and Analgesia [E03]
Gender: Female, Male. Age: 18-64 years, 65+ years. Enrolment: 240.
Status: Ongoing, recruiting. Start date (EU): 2025-11-19. Decision date: 2025-11-10. Results received: No. Last updated: 2026-02-02.

Condition(s): Patients undergoing vitrectomy and/or cataract surgery
Product: Nervenruh forte - Dragees, Bromazepam Genericon 3 mg Filmtabletten

Primary endpoint: NRS-P score 30 seconds after retrobulbar block.
Endpoint(s): STAI Questionnaire at admission; NRS-P and NRS-A before retrobulbar injection; NRS-P score 30 seconds after retrobulbar block; NRS-P and NRS-A score directly after operation; Speed rate/duration of retrobulbar injection

Source: https://euclinicaltrials.eu/ctis-public/view/2024-520132-15-00